EU clinical trial 2023-503729-20-00: Open-Label Extension Study of PRX012 in Subjects with Alzheimer’s Disease Who Were Enrolled in Study PRX012-101 or PRX012-102
Protocol code: PRX012-103
Sponsor: Othair Prothena Limited (Pharmaceutical company). Phase: Human Pharmacology (Phase I)- Other. Countries: Spain (ended), Poland (ended).
Therapeutic area(s): Diseases [C] - Nervous System Diseases [C10]
Gender: Female, Male. Age: 18-64 years, 65+ years. Enrolment: 40.
Status: Ended. Start date (EU): 2024-03-27. End date (EU): 2025-08-27. End date: 2026-01-16. Decision date: 2024-01-29. Results received: No. Last updated: 2025-07-28.
Decision dates by country: PL: 2024-01-29, ES: 2024-02-28

Condition(s): Alzheimer’s Disease

Source: https://euclinicaltrials.eu/ctis-public/view/2023-503729-20-00